EU clinical trial 2022-501310-57-00: A Phase 2a/b, Randomized, Double-blind, Placebo-controlled, Parallel Group, Multicenter, Clinical Study to Evaluate the Efficacy and Safety of OG-6219 in 3 Dose Levels, in Women 18 to 49 Years of Age with Moderate to Severe Endometriosis-related Pain
Protocol code: OG-6219-P001
Sponsor: Organon LLC (Pharmaceutical company). Phase: Therapeutic exploratory (Phase II). Countries: Bulgaria (ended), Latvia (ended), Germany (ended), Italy (ended), Czechia (ended), Belgium (ended), Hungary (ended), Poland (ended), Sweden (ended), France (ended).
Therapeutic area(s): Diseases [C] - Female Urogenital Diseases and Pregnancy Complications [C13]
Gender: Female. Age: 18-64 years. Enrolment: 352.
Status: Ended. Start date (EU): 2024-02-05. End date (EU): 2025-05-27. End date: 2025-05-28. Decision date: 2023-04-24. Results received: Yes. Last updated: 2025-03-14.
Decision dates by country: DE: 2023-05-30, FR: 2023-06-02, BE: 2023-05-15, LV: 2023-05-25, CZ: 2023-05-05, BG: 2023-04-24, IT: 2023-05-17, HU: 2023-05-24, PL: 2023-04-26, SE: 2023-06-09

Condition(s): Endometriosis related pain
Product: Placebo Tablet for OG-6219, Nalgesin S 275 mg plėvele dengtos tabletės

Primary endpoint: Change from BC to TRC3 in the mean OPP score, Proportion of participants who experienced any AEs/SAEs, Abnormalities in clinical laboratory assessments, vital signs, and physical examination, Proportion of participants who prematurely discontinued study treatment due to AEs/SAEs
Endpoint(s): Change from BC to TRC3 the mean DYS score, Change from BC to TRC3 of the mean NMPP score, Change from BC to TRC3 in the mean dyspareunia score, Change from BC to TRC1, TRC2, and TRC3 in the mean number of tablets of rescue medication for ERP, Change from BC to TRC1, TRC2, and TRC3 in the proportion of days participant has used rescue medication for ERP, Change in PGI-S Score from V4 to Phone Contact 1, V6, and V7, Percentage of participants with any improvement in the PGI-C at TRC1, TRC2, and TRC3., Change from BC to TRC3 in the EHP-30 Domain Scores, Mean change from V1 to V7 in bone biomarker levels, Proportion of participants with clinical parameters of significance from V1 to V5, V6, V7, and V8, Mean change from BC to TRC1, TRC2, TRC3 in the percentage of days with vaginal bleeding, ECG parameter changes at V4, V5, V6, and V7, Main change from scoreV1 to V7 in serum hormone levels, Serum hormone levels comparing Group A (50 mg BID), B (100 mg BID), C (150 mg BID) with Group D (Placebo), Serum hormone levels at V7 comparing Group A (50 mg BID), B (100 mg BID), C (150 mg BID) with Group D (Placebo), Plasma concentrations of OG-6219 and FOR-1011 at scheduled assessments using sparse PK sampling during the treatment period., Cmax, Tmax, and AUCtau for both OG-6219 and FOR-1011 on V4 and V5 for the population with intensive PK sampling

Source: https://euclinicaltrials.eu/ctis-public/view/2022-501310-57-00